EU clinical trial 2024-511378-60-00: A Phase 3 Randomized, Double-Blind, Placebo-Controlled, Global Study to Evaluate the Efficacy and Safety of Intravenous AOC 1001 for the Treatment of Myotonic Dystrophy Type 1
Protocol code: AOC 1001-CS3
Sponsor: Avidity Biosciences Inc. (Pharmaceutical company). Phase: Therapeutic confirmatory (Phase III). Countries: Netherlands (ended), France (ended), Spain (ended), Denmark (ongoing, recruitment ended), Italy (ended), Ireland (ended), Germany (ended).
Therapeutic area(s): Diseases [C] - Musculoskeletal Diseases [C05]
Gender: Female, Male. Age: 0-17 years, 18-64 years. Enrolment: 39.
Start date (EU): 2024-12-11. Decision date: 2024-08-08. Results received: No. Last updated: 2026-06-01.
Decision dates by country: FR: 2024-09-19, DE: 2024-09-19, DK: 2024-08-21, IE: 2024-09-20, NL: 2024-09-17, IT: 2024-09-23, ES: 2024-08-08

Condition(s): Myotonic Dystrophy Type 1
Product: 0.9% Saline for IV administration, AOC 1001, AOC 1001

Primary endpoint: Change from baseline to Week 54 in video Hand Opening Time (vHOT).
Endpoint(s): 1. Change from baseline to Week 54 in: • Hand grip strength. • QMT total composite score. • DM1-ActivC. • 10MWRT, 2. Change from baseline to Week 54 in: • QMT upper extremity composite score. • QMT lower extremity composite score. • QMT individual muscle group scores. • PGI-S. • EQ-5D-5L. PGI-C at Week 54

Source: https://euclinicaltrials.eu/ctis-public/view/2024-511378-60-00